EU clinical trial 2024-513526-27-00: Prospective, randomized study concerning personalized medicine with Pentaglobin® after interventional infectious source control in peritonitis patients
Protocol code: 15-167
Sponsor: Universitaetsklinikum Aachen AöR (Hospital/Clinic/Other health care facility). Phase: Therapeutic exploratory (Phase II). Countries: Austria (ongoing, recruiting), Germany (ongoing, recruiting).
Therapeutic area(s): Phenomena and Processes [G] - Immune system processes [G12]
Gender: Female, Male. Age: 18-64 years, 65+ years. Enrolment: 200.
Status: Ongoing, recruiting. Start date (EU): 2018-02-23. Decision date: 2024-05-29. Results received: No. Last updated: 2026-04-01.
Decision dates by country: AT: 2024-05-29, DE: 2024-06-25

Condition(s): secondary or quaternary peritonitis, sepsis
Product: Pentaglobin 50 g/l Infusionslösung, Pentaglobin 50 mg/ml Infusionslösung

Primary endpoint: Change in multiple organ failure (MOF) score (determined in the organs lung, heart, kidney, liver, blood) from baseline to day 7 after source control, in the course of peritonitis.
Endpoint(s): Death within 28 days, Death within 90 days, Change in MOF score from baseline to day 5, Multi-organ failure (> 4 MOF points) on day 7

Source: https://euclinicaltrials.eu/ctis-public/view/2024-513526-27-00